EU clinical trial 2024-516578-31-00: Efficacy of nasal oxygen therapy on the reduction of postoperative complications in ankle trauma surgery in at-risk patients: a randomized pilot study
Protocol code: RC21_0129
Sponsor: Centre Hospitalier Universitaire De Nantes (Hospital/Clinic/Other health care facility). Phase: Therapeutic confirmatory (Phase III). Countries: France (ended).
Therapeutic area(s): Diseases [C] - Skin and Connective Tissue Diseases [C17]
Gender: Female, Male. Age: 18-64 years, 65+ years. Enrolment: 200.
Status: Ended. Start date (EU): 2024-08-21. End date (EU): 2026-07-15. Decision date: 2024-08-21. Results received: No. Last updated: 2024-08-21.

Condition(s): Oxygen therapy in trauma ankle surgery patients
Product: OXYGENE MEDICINAL LIQUIDE LINDE HEALTHCARE, gaz pour inhalation, pour évaporateur fixe et pour récipient cryogénique fixe

Primary endpoint: Cutaneous and infectious complications within 6 months postoperatively: skin suffering (ecchymosis, phlyctenes), necrosis, superficial and deep infection and scar disunion.
Endpoint(s): Observer Scar Assessment Scale (OSAS) questionnaire, W3, W6 and W12, Surgical resumption within 6 months after surgery, Presence of delayed consolidation on radiograph at W12; and if so, presence of pseudarthrosis on radiograph at 24 weeks post-op (W24, Pain VAS preoperatively, at H24, H48, W3, W6, W12 and W24, Measurement of TcPO2 before the start of oxygen therapy pre-operatively, then at H48, W3. These measurements will be performed in a subgroup of 40 patients (20 patients in each subgroup), Incremental cost-utility ratio over a 24-week time horizon (QALY assessed by EQ-5D self-questionnaire pre-operatively and at H48, W3, W6 and W12 and W24)

Source: https://euclinicaltrials.eu/ctis-public/view/2024-516578-31-00